EU clinical trial 2025-520714-63-00: A Phase III b randomized open-label trial on metformin for cancer prevention in adolescents and adults with Li-Fraumeni syndrome (LFS)
Protocol code: LFS-Metformin-Trial
Sponsor: Medizinische Hochschule Hannover (Educational Institution). Phase: Therapeutic confirmatory (Phase III). Countries: Germany (ongoing, recruiting).
Therapeutic area(s): Diseases [C] - Congenital, Hereditary, and Neonatal Diseases and Abnormalities [C16]
Gender: Female, Male. Age: 0-17 years, 18-64 years, 65+ years. Enrolment: 330.
Status: Ongoing, recruiting. Start date (EU): 2026-01-05. Decision date: 2025-08-27. Results received: No. Last updated: 2026-07-23.

Condition(s): Li-Fraumeni syndrome
Product: METFORMIN, METFORMIN, METFORMIN HYDROCHLORIDE

Primary endpoint: Cancer-free survival (CFS) as time between randomization and “cancer” event defined as histologically confirmed cancer diagnosis established during trial participation or death from any cause
Endpoint(s): Tumor-free survival (TFS) as time between randomization and a “tumor” event including diagnosis of histologically confirmed cancer or clinically or radiologically detected benign or premalignant lesion identified during trial participation or death from any cause, Time from randomization to death from any cause during trial participation, Number and type of emerging cancers, including size, stage and histological grade at diagnosis, Treatment-emergent (serious) adverse events (AEs, SAEs), Levels of metformin adherence described by the aggregated MARS-5 scores, Change of QoL, FOP, levels of depression and anxiety and distress during the trial, Change in QoL, FOP, levels of depression and anxiety and distress from baseline to last visit, Correlation of baseline weight, BMI and lifestyle factors (e. g. smoking) with outcome

Source: https://euclinicaltrials.eu/ctis-public/view/2025-520714-63-00